EU clinical trial 2023-503693-20-01: A randomized, double-blind, placebo-controlled, parallel-group study to assess the efficacy, safety, and tolerability of dexpramipexole administered orally for 52 weeks in participants with severe eosinophilic asthma (EXHALE-3)
Protocol code: AR-DEX-22-02
Sponsor: Areteia Therapeutics Inc. (Pharmaceutical company). Phase: Therapeutic confirmatory (Phase III). Countries: Czechia (ended), Spain (ended), Germany (ended), Austria (ended), Lithuania (ended), Hungary (ended), Italy (ended), France (ended), Croatia (ended).
Therapeutic area(s): Diseases [C] - Respiratory Tract Diseases [C08]
Gender: Female, Male. Age: 18-64 years, 65+ years. Enrolment: 490.
Status: Ended. Start date (EU): 2024-04-10. End date (EU): 2025-11-05. Decision date: 2024-03-12. Results received: No. Last updated: 2025-12-16.
Decision dates by country: LT: 2024-03-18, HR: 2024-07-08, FR: 2024-06-27, AT: 2024-03-18, IT: 2024-06-12, HU: 2024-03-14, ES: 2024-04-25, CZ: 2024-03-13, DE: 2024-05-15

Condition(s): Severe eosinophilic asthma
Product: Placebo, Ventolin 100 microgramos/inhalación suspensión para inhalación en envase a presión* (*) sin CFC, Novolizer Salbutamol Meda 100 Mikrogramm/Dosis Pulver zur Inhalation, Ventolin Inhaler N Suspenze k inhalaci v tlakovém obalu, Sultanol Dosier-Aerosol 100 Mikrogramm/Dosis Druckgasinhalation, Suspension, Ventolin 100 mikrogramų/išpurškime suslėgtoji įkvepiamoji suspensija, Dexpramipexole (KNS-760704), Budesonide/Formoterol Teva Pharma B.V. 160 micrograms / 4.5 micrograms inhalation powder, Dexpramipexole (KNS-760704), Ventolin Evohaler túlnyomásos inhalációs szuszpenzió

Primary endpoint: Annualized rate of severe asthma exacerbations (AAER) over 52 weeks.
Endpoint(s): Pre-BD FEV1, absolute change from baseline, averaged across visits at Weeks 36, 44, and 52., Asthma Control Questionnaire-6 (ACQ-6), change from baseline, averaged across visits at Weeks 36, 44, and 52., Standardized version of the Asthma Quality of Life Questionnaire for 12 years and older (AQLQ+12), change from baseline to Week 52.

Source: https://euclinicaltrials.eu/ctis-public/view/2023-503693-20-01